EU clinical trial 2024-520288-15-00: RAXO trial - A population-based prospective study to evaluate clinical behaviour, resectability and survival in metastatic colorectal cancer patients in Finland
Sponsor: HUS-Yhtymae (Hospital/Clinic/Other health care facility). Phase: Therapeutic use (Phase IV). Countries: Finland (ongoing, recruiting).
Therapeutic area(s): Diseases [C] - Neoplasms [C04]
Gender: Female, Male. Age: 18-64 years, 65+ years. Enrolment: 60000.
Status: Ongoing, recruiting. Start date (EU): 2025-01-25. Decision date: 2025-01-24. Results received: No. Last updated: 2025-12-19.

Condition(s): Metastatic or locally advanced inoperable colorectal cancer
Product: Capecitabine Orion 500 mg kalvopäällysteiset tabletit, Fluorouracil Accord 50 mg/ml injektio-/infuusioneste, liuos

Primary endpoint: Primary objective: • To assess clinical behaviour of metastatic colorectal cancer and overall resectability, postoperative morbidity and outcomes after resection

Source: https://euclinicaltrials.eu/ctis-public/view/2024-520288-15-00